EU clinical trial 2022-502833-25-00: J2A-MC-GZGS: A Phase 3, Open-Label Study of Once Daily Orforglipron Compared with Insulin Glargine in Adult Participants with Type 2 Diabetes and Obesity or Overweight at Increased Cardiovascular Risk (ACHIEVE-4)
Protocol code: J2A-MC-GZGS
Sponsor: Eli Lilly & Co. (Pharmaceutical company). Phase: Therapeutic confirmatory (Phase III). Countries: Greece (ended), Germany (ended), Austria (ended), Romania (ended), Slovakia (ended), Czechia (ended), Spain (ended), Italy (ended).
Therapeutic area(s): Diseases [C] - Nutritional and Metabolic Diseases [C18]
Gender: Female, Male. Age: 18-64 years, 65+ years. Enrolment: 1040.
Status: Ended. Start date (EU): 2023-08-02. End date (EU): 2026-03-16. End date: 2026-03-17. Decision date: 2023-08-01. Results received: No. Last updated: 2026-07-10.
Decision dates by country: ES: 2023-08-03, DE: 2023-08-02, RO: 2023-08-07, SK: 2023-08-02, AT: 2023-08-04, CZ: 2023-08-03, GR: 2023-08-01, IT: 2023-08-04

Condition(s): Type 2 Diabetes, Overweight or Obesity, Overweight, Cardiovascular Diseases, Obesity, Chronic Kidney disease
Product: ABASAGLAR 100 units/mL KwikPen solution for injection in a pre-filled pen, ORFORGLIPRON, DAPAGLIFLOZIN, ORFORGLIPRON, EMPAGLIFLOZIN, ORFORGLIPRON, ORFORGLIPRON, CANAGLIFLOZIN, ORFORGLIPRON, EMPAGLIFLOZIN, CANAGLIFLOZIN, DAPAGLIFLOZIN, Orforglipron, ERTUGLIFLOZIN, ERTUGLIFLOZIN

Primary endpoint: Time to First Occurrence of Any Major Adverse Cardiovascular Event (MACE-4) [Myocardial Infarction (MI), Stroke, Hospitalization for Unstable Angina, or Cardiovascular (CV) death]

Source: https://euclinicaltrials.eu/ctis-public/view/2022-502833-25-00